EU clinical trial 2024-510932-36-00: ARGX-113-2003: A Phase 3B, Randomized, Open-Label, Parallel-Group Study to Evaluate Different Dosing Regimens of Intravenous Efgartigimod to Maximize and Maintain Clinical Benefit in Patients With Generalized Myasthenia Gravis
Protocol code: ARGX-113-2003
Sponsor: Argenx (Pharmaceutical company). Phase: Therapeutic confirmatory (Phase III). Countries: Spain (ended), Italy (ended), Austria (ended), Germany (ended), Belgium (ended), France (ended), Poland (ended).
Therapeutic area(s): Diseases [C] - Immune System Diseases [C20]
Gender: Female, Male. Age: 18-64 years, 65+ years. Enrolment: 42.
Status: Ended. Start date (EU): 2021-12-21. End date (EU): 2025-10-06. End date: 2025-10-07. Decision date: 2024-09-08. Results received: No. Last updated: 2025-10-15.
Decision dates by country: AT: 2024-09-08, BE: 2024-09-09, FR: 2024-09-10, DE: 2024-09-10, IT: 2024-09-17, ES: 2024-09-09, PL: 2024-10-05

Condition(s): Generalized Myasthenia Gravis (gMG)
Product: Vyvgart 20 mg/mL concentrate for solution for infusion

Primary endpoint: Mean of the average MG-ADL total score change from baseline during the visit of week (W)1 through W21 by regimen arm
Endpoint(s): Incidence and severity of AEs, incidence of serious adverse events (SAEs), incidence of AESIs, and changes in laboratory test results, vital sign measurements, and electrocardiogram results, Change from baseline in the MG-ADL total score over time, Normalized area under the effect curve (AUEC) of MG-ADL total score improvement from baseline during the following intervals: day 1 through W7; W7 through W14; W14 through W21; W7 through W21, Characterization of MG-ADL total score change from baseline during the following 5 intervals using mean and standard deviation: W1 through W7; W8 through W14; W15 through W21; W8 through W21; W1 through W21, Number and percentage of participants who have a ≥ 2, 3, 4, or 5 points improvement in MG-ADL total score from baseline during the following 5 intervals: W1 through W7; W8 through W14; W15 through W21; W8 through W21; W1 through W21, Percentage of time participants have a reduction in MG-ADL total score of at least 2 points from baseline during W4 through W21, Number and percentage of participants who achieve minimal symptom expression (MSE), defined as a MG-ADL total score of 0 or 1, in the following 5 intervals: W1 through W7; W8 through W14; W15 through W21; W8 through W21; W1 through W21

Source: https://euclinicaltrials.eu/ctis-public/view/2024-510932-36-00